EU clinical trial 2024-514293-46-00: Phase II non randomized clinical trial of NIVOLUMAB/IPILIMUMAB maintenance following first-line chemotherapy in unresectable locally advanced or metastatic urothelial cancer (SOGUG-VEXILLUM)
Sponsor: Grupo Espanol De Oncologia Genitourinaria-Socug (Patient organisation/association). Phase: Therapeutic exploratory (Phase II). Countries: Spain (ended).
Therapeutic area(s): Diseases [C] - Neoplasms [C04]
Gender: Female, Male. Age: 18-64 years, 65+ years. Enrolment: 25.
Status: Ended. Start date (EU): 2022-07-07. End date (EU): 2025-07-10. Decision date: 2024-06-20. Results received: Yes. Last updated: 2024-06-20.

Condition(s): Unresectable locally advanced or metastatic urothelial cancer
Product: OPDIVO 10 mg/mL concentrate for solution for infusion., YERVOY 5 mg/ml concentrate for solution for infusion

Primary endpoint: PFS in the overall population and in the PD-L1 positive population. PFS is defined as the time from the first dose of study treatment date until disease progression or death from any cause. Patients who have not progressed and start a new line of treatment will be censored at the date of the last adequate tumor assessment prior to starting the next line of therapy
Endpoint(s): Overall Survival (OS), Objective response (ORR), Clinical benefit rate (CBR), Duration of response (DOR), PFS from start of first line chemotherapy (cPFS), OS from start of first line chemotherapy (cOS), Adverse events (AE), Treatment related adverse events (TRAEs), Patient reported outcomes through the EORTC QLQ-C30 and EQ-5D-5L questionnaires

Source: https://euclinicaltrials.eu/ctis-public/view/2024-514293-46-00